EU clinical trial 2024-510811-32-00: ASPAPY - Aspirin in acute pneumonia in the elderly: a multicenter, double-blind, randomized, placebo-controlled trial
Protocol code: ASPAPY
Sponsor: Centre Hospitalier Universitaire De Dijon (Hospital/Clinic/Other health care facility). Phase: Therapeutic confirmatory (Phase III). Countries: France (authorised, recruitment pending).
Therapeutic area(s): Diseases [C] - Respiratory Tract Diseases [C08]
Gender: Female, Male. Age: 65+ years. Enrolment: 600.
Status: Authorised, recruitment pending. Decision date: 2024-12-04. Results received: No. Last updated: 2025-09-10.

Condition(s): acute pneumonia
Product: ACIDE ACETYLSALICYLIQUE PANPHARMA 500 mg, poudre pour solution injectable, CHLORURE DE SODIUM 0,9 % VIAFLO, solution pour perfusion, ASPIRINE PROTECT 100 mg, comprimé gastro-resistant, Placebo d'acide acétylsalicylique

Primary endpoint: All-cause mortality at D90 after randomization
Endpoint(s): EFFICACY: All-cause mortality at D30 and D120, EFFICACY: CV mortality at D30, D90 and D120 (i.e. mortality related to major CV events*), EFFICACY: Occurrence of major CV events (composite endpoint including at least one of the following: *myocardial infarction, stroke, heart failure, new atrial fibrillation, pulmonary embolism, CV death, sudden death) within 30 days, 90 days and 120 days of randomization, EFFICACY: Number of days in intensive care or resuscitation unit within 30 days and 90 days of randomization, EFFICACY: Occurrence of re-hospitalization (unscheduled hospitalization) within 30 and 90 days of randomization, EFFICACY: Duration in days of first hospitalization (excluding follow-up care, rehabilitation and long-term care units), EFFICACY: Proportion of newly institutionalized patients (i.e. entering a nursing home) at D90 and proportion of patients with a decrease ≥ 1 point on the activity of daily living (ADL) scale between their pre-randomization status and D90, EFFICACY: Time (in days) to death from any cause, end of study (D120) or date of last follow-up, whichever comes first, EFFICACY: Time (in days) to major CV event, death, end of study (D120) or date of last follow-up, whichever comes first, TOLERANCE: Frequency of major bleeding events (BARC classification >2) within 30 days, 90 days and 120 days of randomization, TOLERANCE: Frequency of bleeding events (any severity) within 30 days, 90 days and 120 days of randomization

Source: https://euclinicaltrials.eu/ctis-public/view/2024-510811-32-00